EU clinical trial 2024-513523-16-00: Cook´s balloon versus dinoprostone for Labor Induction of term pregnancies with fetal GROWth restriction (COLIGROW study)
Protocol code: COLIGROW
Sponsor: Hospital Universitario 12 De Octubre (Hospital/Clinic/Other health care facility). Phase: Therapeutic confirmatory (Phase III). Countries: Spain (ended).
Therapeutic area(s): Diseases [C] - Female Urogenital Diseases and Pregnancy Complications [C13]
Gender: Female. Age: 18-64 years. Enrolment: 172.
Status: Ended. Start date (EU): 2023-03-16. End date (EU): 2025-12-18. Decision date: 2024-04-15. Results received: No. Last updated: 2024-04-15.

Condition(s): Fetal growth restriction
Product: PROPESS 10 mg sistema de liberación vaginal

Primary endpoint: Vaginal delivery; [yes/no]

Source: https://euclinicaltrials.eu/ctis-public/view/2024-513523-16-00